EU clinical trial 2025-521407-52-00: A Phase 1 Study of JNJ-89862175, an Ectonucleotide Pyrophosphatase/Phosphodiesterase Family Member 3 Antibody Drug Conjugate, for Advanced Solid Tumors.
Protocol code: 89862175LUC1001
Sponsor: Janssen Cilag International (Pharmaceutical company). Phase: Human Pharmacology (Phase I)- First administration to humans. Countries: France (ongoing, recruiting).
Therapeutic area(s): Diseases [C] - Neoplasms [C04]
Gender: Female, Male. Age: 18-64 years, 65+ years. Enrolment: 120.
Status: Ongoing, recruiting. Start date (EU): 2025-12-16. Decision date: 2025-11-21. Results received: No. Last updated: 2026-07-21.

Condition(s): Advanced Solid Tumors

Source: https://euclinicaltrials.eu/ctis-public/view/2025-521407-52-00